EU clinical trial 2023-504772-21-00: VItamin C in Thermal injuRY: The VICToRY Trial A phase III multi-center randomized trial
Protocol code: 19-211
Sponsor: Queen's University (Educational Institution). Phase: Therapeutic exploratory (Phase II). Countries: Belgium (ended), Germany (ended), France (ended), Italy (ended), Portugal (ended).
Therapeutic area(s): Diseases [C] - Disorders of Environmental Origin [C21]
Gender: Female, Male. Age: 18-64 years, 65+ years. Enrolment: 339.
Status: Ended. Start date (EU): 2022-11-22. End date (EU): 2026-03-20. Decision date: 2023-07-24. Results received: No. Last updated: 2025-02-04.
Decision dates by country: DE: 2023-07-26, BE: 2023-07-24, IT: 2024-03-18, PT: 2024-04-16, FR: 2024-04-19

Condition(s): Severely burned patients
Product: D5W (dextrose 5% in water), NaCl solution, ASCORBIC ACID

Primary endpoint: • Persistent organ dysfunction (PODS)+death at 28 days, a novel composite endpoint that combines being alive and being free of organ support (inotropes or vasopressors, renal replacement therapy and mechanical ventilation).
Endpoint(s): • The most important secondary endpoint of this trial will be “time to discharge alive from hospital“., • The other secondary outcomes will be the components of 28-day POD which include mortality, use of inotropes or vasopressors or mechanical circulatory assistance, renal replacement therapy and mechanical ventilation and POD-free days in the first 28 days.

Source: https://euclinicaltrials.eu/ctis-public/view/2023-504772-21-00